EU clinical trial 2022-503027-10-00: A randomized, double-blind, placebo-controlled, phase I/II trial of multi-donor fecal microbiota transfer for maintenance of Remission after Induction treatment with Exclusive Enteral Nutrition (EEN) in CroHn’s disease (EEN-RICH study)
Protocol code: IBD-EEN-RICH_01
Sponsor: Klinikum Der Universitat Munchen AöR (Hospital/Clinic/Other health care facility). Phase: Phase I and Phase II (Integrated)- Other. Countries: Germany (ongoing, recruiting).
Therapeutic area(s): Diseases [C] - Digestive System Diseases [C06]
Gender: Female, Male. Age: 0-17 years, 18-64 years. Enrolment: 24.
Status: Ongoing, recruiting. Start date (EU): 2025-01-21. Decision date: 2023-07-19. Results received: No. Last updated: 2026-06-05.

Condition(s): Crohn's disease
Product: INTESTIFIX 001, INTESTIFIX 001 Placebo capsules

Primary endpoint: Incidence and severity of adverse events and serious adverse events in multi-donor-FMT-group compared to placebo, Summary of adjudicated safety events (e.g., opportunistic infection)
Endpoint(s): 1. To evaluate the feasibility of multi-donor FMT for maintenance of remission after induction treatment with EEN in CD (week -8 to 32) a.) Rate of recruitment of patients, 1. To evaluate the feasibility of multi-donor FMT for maintenance of remission after induction treatment with EEN in CD (week -8 to 32) b.) Study withdrawal rates, 1. To evaluate the feasibility of multi-donor FMT for maintenance of remission after induction treatment with EEN in CD (week -8 to 32) c) Adherence rate to EEN as determined by the proportion of patients with undetectable fecal gluten immunogenic peptides (GIP), 1. To evaluate the feasibility of multi-donor FMT for maintenance of remission after induction treatment with EEN in CD (week -8 to 32) d.) Proportion of patients having taken all capsules during the intervention period, 1. To evaluate the feasibility of multi-donor FMT for maintenance of remission after induction treatment with EEN in CD (week -8 to 32) e) Difference between the number of biosamples collected and the total number of biosamples scheduled per patient as a marker for completeness of sample collection, 2. To evaluate overall clinical efficacy of multi-donor FMT a. Difference in fecal calprotectin levels between week 0 and week 8 in multi-donor FMT compared to placebo, 2. To evaluate overall clinical efficacy of multi-donor FMT b) Difference in C-reactive protein (CRP) levels between baseline (week 0) and week 8 in multi-donor FMT compared to placebo, 2. To evaluate overall clinical efficacy of multi-donor FMT c) Change in CRP and fecal calprotectin levels over time (multi-donor FMT compared to placebo) (week -8 to 32), 2. To evaluate overall clinical efficacy of multi-donor FMT d) Relapse-free survival time (multi-donor FMT compared to placebo) (week 0 to 32), 2. To evaluate overall clinical efficacy of multi-donor FMT e) Clinical remission by physician global assessment at weeks 0, 4, 8, 12, 16, 24 and 32 (multi-donor FMT compared to placebo), 2. To evaluate overall clinical efficacy of multi-donor FMT f) Clinical remission by PCDAI and wPCDAI (children) / CDAI (adults) score at weeks 0, 4, 8, 12, 16, 24 and 32 (multi-donor FMT compared to placebo), 2. To evaluate overall clinical efficacy of multi-donor FMT g) Change from baseline (week -8) in PCDAI, shPCDAI and wPCDAI (children) / CDAI and HBI (adults) over time (multi-donor FMT compared to placebo), 2. To evaluate overall clinical efficacy of multi-donor FMT h) Response by intestinal ultrasound (IUS) at weeks 0, 4, 8, 16 and 32 (multi-donor FMT compared to placebo) in patients with increased bowel wall thickness (BWT) before EEN (week -8)., 2. To evaluate overall clinical efficacy of multi-donor FMT i) Remission by IUS at weeks 0, 4, 8, 16 and 32 (multi-donor FMT compared to placebo)., 2. To evaluate overall clinical efficacy of multi-donor FMT j) Change from baseline (week -8) in IUS parameters over time (multi-donor FMT compared to placebo)., 2. To evaluate overall clinical efficacy of multi-donor FMT k) Prediction of clinical recurrence based on change of IUS parameters over time., 3. To evaluate patient reported outcomes and quality of life (QoL) (week -8 to 32) a) Change from baseline (week -8) in QoL IMPACT-III scores at weeks 0, 4, 8, 16, 32 (multi-donor FMT compared to placebo), 3. To evaluate patient reported outcomes and quality of life (QoL) (week -8 to 32) b) Change from baseline (week -8) in QoL SIBDQ scores at weeks 0, 4, 8, 16, 32 (multi-donor FMT compared to placebo)

Source: https://euclinicaltrials.eu/ctis-public/view/2022-503027-10-00